EU clinical trial 2023-508757-75-00: A Phase 3, Randomized Study of Nivolumab plus Ipilimumab in Combination with Chemotherapy vs Chemotherapy alone as First Line Therapy in Stage IV Non-Small Cell Lung Cancer (NSCLC)
Protocol code: CA209-9LA
Sponsor: Bristol Myers Squibb International Corporation (Pharmaceutical company). Phase: Therapeutic confirmatory (Phase III). Countries: Spain (ended), Ireland (ended), Poland (ended), Belgium (ended), France (ended), Germany (ended), Romania (ended).
Therapeutic area(s): Diseases [C] - Neoplasms [C04]
Gender: Female, Male. Age: 18-64 years, 65+ years. Enrolment: 456.
Status: Ended. Start date (EU): 2017-09-18. End date (EU): 2024-10-18. End date: 2024-10-19. Decision date: 2024-03-01. Results received: Yes. Last updated: 2024-10-28.
Decision dates by country: RO: 2024-03-15, FR: 2024-03-06, IE: 2024-03-01, BE: 2024-03-18, ES: 2024-03-01, PL: 2024-04-09, DE: 2024-03-06

Condition(s): Stage IV Non-Small Cell Lung Cancer (NSCLC)
Product: Paclitaxel Aurobindo 6 mg/ml Konzentrat zur Herstellung einer Infusionslösung, Ipilimumab, Cisplatin Teva® 1 mg/ml Konzentrat zur Herstellung einer Infusionslösung, CARBOPLATIN, ALIMTA 500 mg powder for concentrate for solution for infusion, Cisplatin NeoCorp 1 mg/ml - Konzentrat zur Herstellung einer Infusionslösung, TAXOL 6 mg/ml, concentrato per soluzione per infusione., OPDIVO 10 mg/mL concentrate for solution for infusion., Paclitaxel-GRY® 6 mg/ml Konzentrat zur Herstellung einer Infusionslösung, CISPLATIN-EBEWE, 1 MG/ML, KONCENTRAT DO SPORZĄDZANIA ROZTWORU DO INFUZJI

Primary endpoint: Overall Survival (OS): To compare the efficacy of nivolumab + ipilimumab combined with chemotherapy versus (vs)chemotherapy
Endpoint(s): Progression Free Survival (PFS): To compare the efficacy of nivolumab + ipilimumab combined with chemotherapy vs chemotherapy, Overall Response Rate (ORR): To compare the efficacy of nivolumab + ipilimumab combined with chemotherapy vs chemotherapy, ORR: In participants with different PD-L1 levels, PFS: In participants with different PD-L1 levels, OS: In participants with different PD-L1 levels, ORR: In association with tumor cell total somatic mutation numbers, PFS: In association with tumor cell total somatic mutation numbers, OS: In association with tumor cell total somatic mutation numbers, Blood TMB analysis

Source: https://euclinicaltrials.eu/ctis-public/view/2023-508757-75-00